EU clinical trial 2024-511929-60-00: Efficacy and safety of Carfilzomib in combination with Ibrutinib vs. Ibrutinib alone in Waldenström’s Macroglobulinemia (CZAR-1)
Protocol code: CZAR-1
Sponsor: Universitaetsklinikum Ulm AöR (Hospital/Clinic/Other health care facility). Phase: Therapeutic exploratory (Phase II). Countries: Germany (ongoing, recruitment ended), Greece (ongoing, recruitment ended), Austria (ongoing, recruitment ended).
Therapeutic area(s): Diseases [C] - Hemic and Lymphatic Diseases [C15]; Diseases [C] - Neoplasms [C04]
Gender: Female, Male. Age: 18-64 years, 65+ years. Enrolment: 105.
Status: Ongoing, recruitment ended. Start date (EU): 2021-01-28. Decision date: 2024-10-09. Results received: No. Last updated: 2026-02-27.
Decision dates by country: AT: 2024-10-14, GR: 2025-01-09, DE: 2024-10-09

Condition(s): Waldenström’s Macroglobulinemia
Product: IMBRUVICA 140 mg hard capsules, Kyprolis 60 mg powder for solution for infusion

Primary endpoint: Complete Remission (CR) or Very Good Partial Remission (VGPR) 12 months from randomization using the modified response criteria updated at the Sixth IWWM[1] (CR/VGPR).
Endpoint(s): Response rate (CR, VGPR, PR, MR) and ORR (CR, VGPR, PR) 12 months, Response rate (CR, VGPR, PR, MR) and ORR (CR, VGPR, PR) 24 monthsResponse rate (CR, VGPR, PR, MR) and ORR (CR, VGPR, PR) 24 months, Best response, Time to best response, Time to first response, Time to treatment failure, Remission Duration, Progression free survival, Cause specific survival, Overall survival, Safety, Quality of life

Source: https://euclinicaltrials.eu/ctis-public/view/2024-511929-60-00